EU clinical trial 2024-517952-37-00: Dose escalation/expansion trial with BYON4228 alone and in combination in metastatic solid tumors
Protocol code: BYON4228.002
Sponsor: Byondis B.V. (Pharmaceutical company). Phase: Phase I and Phase II (Integrated)- Other. Countries: Spain (ongoing, recruitment ended), Belgium (ended).
Therapeutic area(s): Diseases [C] - Neoplasms [C04]
Gender: Female, Male. Age: 18-64 years, 65+ years. Enrolment: 63.
Start date (EU): 2025-05-22. Decision date: 2025-04-30. Results received: No. Last updated: 2026-07-10.
Decision dates by country: ES: 2025-04-30, BE: 2025-05-05

Condition(s): Locally advanced or metastatic cancer (Solid tumors)

Source: https://euclinicaltrials.eu/ctis-public/view/2024-517952-37-00